EU clinical trial 2023-503971-45-00: A randomized, double-blind, single-center, 2-period cross-over Phase I study to assess the tolerability, safety and pharmacokinetics of antidepressant doses of oral ketamine hydrochloride prolonged release tablets (KET01) compared to intranasal esketamine in healthy male subjects
Protocol code: KET01-03
Sponsor: Ketabon GmbH (Pharmaceutical company). Phase: Human Pharmacology (Phase I)- Other. Countries: Germany (ended).
Therapeutic area(s): Diseases [C] - Nervous System Diseases [C10]
Gender: Male. Age: 18-64 years. Enrolment: 26.
Status: Ended. Start date (EU): 2023-06-01. End date (EU): 2023-08-07. Decision date: 2023-05-19. Results received: Yes. Last updated: 2023-05-19.

Condition(s): Depression
Product: Spravato 28 mg nasal spray, solution, Placebo for Ketamine hydrochloride prolonged release tablet, Ketamine hydrochloride prolonged release tablets, Placebo for Spravato, nasal spray

Primary endpoint: Maximum change in CADSS Score from baseline to any time after IMP administration within the period.

Source: https://euclinicaltrials.eu/ctis-public/view/2023-503971-45-00